EU clinical trial 2024-515717-17-00: A prospective, randomized, double-blind placebo-controlled multicentre trial with mannan-conjugated birch pollen allergoids administered subcutaneously to adolescents and adults with birch pollen-induced allergic rhinitis or rhinoconjunctivitis.
Protocol code: T502-SIT-073
Sponsor: Inmunotek S.L. (Pharmaceutical company). Phase: Therapeutic confirmatory (Phase III). Countries: Germany (ended).
Therapeutic area(s): Diseases [C] - Immune System Diseases [C20]
Gender: Female, Male. Age: 0-17 years, 18-64 years. Enrolment: 360.
Status: Ended. Start date (EU): 2024-10-28. End date (EU): 2025-06-27. Decision date: 2024-10-17. Results received: Yes. Last updated: 2025-08-07.

Condition(s): birch pollen-induced allergic rhinitis birch pollen-induced allergic rhinoconjunctivitis
Product: EMADINE 0.5 mg/ml, eye drops, solution, AVAMYS 27.5 micrograms/spray, nasal spray suspension, Rupatadin AL 10 mg Tabletten, HAL Allergy Prick Test Hundeepithelien, Mometason ratiopharm 50 Mikrogramm/Sprühstoß Nasenspray, Suspension, ALLERGOPHARMA HISTAMIN 1 + 999 zur Positivkontrolle beim Prick-Test; Pricktestlösung zur Anwendung bei Kindern oder Erwachsenen, Flutica-Teva® 50 Mikrogramm Nasenspray, Suspension, Ebastin Aristo 10 mg Filmtabletten, Desloratadin Glenmark 5 mg Tabletten, Placebo will be identical in appearance to the investigational medicinal product., ALK Prick Positiv Kontrolle - Lösung für Haut-Pricktest, Mannan-conjugated allergoid (polymerized) Betula pendula parenteral vaccine, Cetirizin-ratiopharm® bei Allergien Filmtabletten Wirkstoff: Cetirizindihydrochlorid 10 mg, Loratadin-ratiopharm® 10 mg Tabletten, Budes 64 Mikrogramm/Sprühstoß Nasenspray, Suspension, Alvesco 160 Mikrogramm Druckgasinhalation, Lösung, Histamin-Kontrollösung 1% Pricktestlösung Wirkstoff: Histamindihydrochlorid, NASACORT 55 Mikrogramm/Dosis Nasenspray, Suspension, Olopatadin Micro Labs 1 mg/ml Augentropfen, Lösung, HAL Allergy Prick Test Hausstaubmilbe Dermatophagoides Pteronyssinus, Livocab® direkt Augentropfen 0,05 % Augentropfen, Suspension, HAL Allergy Prick Test Katzenepithelien, HAL Allergy Prick Test Birke, Allegra Allergietabletten 20 mg Tabletten, Fexofenadin Winthrop 180 mg Filmtabletten, Bilaxten 6 mg/ml Augentropfen, Lösung, Prick Test Histamin LETI Positivkontrolle 10 mg/ml Pricktestlösung, Levocetirizin-ratiopharm 5 mg Filmtabletten, Azelastin COMOD 0,5 mg/ml Augentropfen, Lösung

Primary endpoint: The clinical impact of T502 treatment will be assessed by comparing the mean daily Combined Symptom and Medication Score (CSMS) over the peak birch pollen season 2025 between the placebo and the active treatment group.

Source: https://euclinicaltrials.eu/ctis-public/view/2024-515717-17-00